EU clinical trial 2024-516754-22-00: An Open-label Extension Study Evaluating the Long-term Safety and Efficacy of Oral Inhalation of GB002 for the Treatment of WHO Group 1 Pulmonary Arterial Hypertension (PAH)
Protocol code: GB002-2102
Sponsor: GB002 Inc. (Pharmaceutical company). Phase: Therapeutic exploratory (Phase II). Countries: Spain (ongoing, recruitment ended), Germany (ongoing, recruitment ended), Czechia (ended).
Therapeutic area(s): Diseases [C] - Cardiovascular Diseases [C14]
Gender: Female, Male. Age: 18-64 years, 65+ years. Enrolment: 11.
Start date (EU): 2021-07-14. Decision date: 2024-11-06. Results received: No. Last updated: 2025-10-07.
Decision dates by country: ES: 2024-11-06, CZ: 2024-11-11, DE: 2024-11-06

Condition(s): Pulmonary Arterial Hypertension (PAH)
Product: GB002

Primary endpoint: Incidence of treatment-emergent adverse events (TEAEs)
Endpoint(s): Change in the distance achieved on six-minute walk test (6MWT), (Δ6MWD)

Source: https://euclinicaltrials.eu/ctis-public/view/2024-516754-22-00